EU clinical trial 2023-504786-23-00: A Phase 1/2 Dose-escalation Study Evaluating the Safety, Tolerability, and Efficacy of VX-522 in Subjects 18 Years of Age and Older With Cystic Fibrosis and a CFTR Genotype Not Responsive to CFTR Modulator Therapy
Protocol code: VX21-522-001
Sponsor: Vertex Pharmaceuticals Inc. (Pharmaceutical company). Phase: Phase I and Phase II (Integrated)- First administration to humans. Countries: Germany (ended), Italy (ended), Netherlands (ended), Belgium (ended), Sweden (ended), Spain (ended).
Therapeutic area(s): Diseases [C] - Congenital, Hereditary, and Neonatal Diseases and Abnormalities [C16]
Gender: Female, Male. Age: 18-64 years. Enrolment: 10.
Status: Ended. Start date (EU): 2024-11-18. End date (EU): 2026-04-21. Decision date: 2023-09-27. Results received: No. Last updated: 2026-04-29.
Decision dates by country: NL: 2023-10-02, DE: 2023-10-02, ES: 2023-10-02, SE: 2023-09-28, BE: 2023-10-02, IT: 2023-09-27

Condition(s): Cystic Fibrosis
Product: VX-522 Nebuliser dispersion, Kalydeco 150 mg film-coated tablets

Primary endpoint: Safety and tolerability, based on the assessment of adverse events (AEs), clinical laboratory values (serum chemistry, hematology, coagulation, and urinalysis), standard 12-lead ECGs, vital signs, pulse oximetry, spirometry, and immune response to VX-522 components and CFTR protein through the Week 8 Visit
Endpoint(s): MAD T1: Change from baseline in percent predicted forced expiratory volume in 1 second (ppFEV1) at Day 29, MAD T2: Change from baseline and pre-Run-in baseline in ppFEV1 at Day 29, Safety based on the assessment of AEs, clinical laboratory values (serum chemistry, hematology, coagulation, and urinalysis), standard 12-lead ECGs, vital signs, pulse oximetry, spirometry, and immune response to VX-522 components and CFTR protein through the Safety Follow-up Visit

Source: https://euclinicaltrials.eu/ctis-public/view/2023-504786-23-00